EU clinical trial 2023-510299-29-00: A clinical gene therapy study with hematopoietic stem cells for the treatment of patients suffering from a malignant neoplasm of the central nervous system
Protocol code: TEM-GBM_001
Sponsor: Genenta Science S.p.A. (Pharmaceutical company). Phase: Phase I and Phase II (Integrated)- First administration to humans. Countries: Italy (ended).
Therapeutic area(s): Diseases [C] - Neoplasms [C04]
Gender: Female, Male. Age: 18-64 years, 65+ years. Enrolment: 27.
Status: Ended. Start date (EU): 2019-03-13. End date (EU): 2026-05-27. Decision date: 2024-02-28. Results received: No. Last updated: 2024-09-09.

Condition(s): Glioblastoma multiforme

Source: https://euclinicaltrials.eu/ctis-public/view/2023-510299-29-00